EU clinical trial 2023-510283-12-00: A Phase 1/2a, First-in-human, Randomized, Double-blinded, Placebo-controlled, Dose-finding Study in Healthy Volunteers and Participants with Sickle Cell Disease to Evaluate the Pharmacokinetics, Pharmacodynamics, Safety and Tolerability, pH and Food Effect, and Preliminary Efficacy of BMS-986470
Protocol code: CA230-1019
Sponsor: Bristol-Myers Squibb Services Unlimited Company (Pharmaceutical company). Phase: Phase I and Phase II (Integrated)- First administration to humans. Countries: France (ongoing, recruiting), Italy (authorised, recruitment pending).
Therapeutic area(s): Diseases [C] - Hemic and Lymphatic Diseases [C15]
Gender: Female, Male. Age: 18-64 years, 65+ years. Enrolment: 12.
Start date (EU): 2025-06-12. Decision date: 2025-05-16. Results received: No. Last updated: 2026-07-02.
Decision dates by country: IT: 2026-07-02, FR: 2025-05-16

Condition(s): Sickle Cell Disease
Product: BMS-986470, BMS-986470, N/A, BMS-986470

Primary endpoint: Incidence of adverse events (AEs), serious adverse events (SAEs), AEs meeting protocol-defined dose limiting toxicity (DLT) criteria, AEs leading to discontinuation, and death.
Endpoint(s): A summary of the exposure levels of the study drug as well as changes in levels of different types of hemoglobin including fetal and sickle forms of hemoglobin., The study will also check whether other markers connected to sickle cell disease are improving

Source: https://euclinicaltrials.eu/ctis-public/view/2023-510283-12-00